EU clinical trial 2023-510081-27-00: An open-label, multi-center, phase 1/2 study to assess safety, efficacy and cellular kinetics of YTB323 in participants with severe, refractory systemic lupus erythematosus (srSLE).
Protocol code: CYTB323G12101
Sponsor: Novartis Pharma AG (Pharmaceutical company). Phase: Phase I and Phase II (Integrated)- Other. Countries: Spain (ongoing, recruitment ended), France (ongoing, recruitment ended), Germany (ended).
Therapeutic area(s): Diseases [C] - Immune System Diseases [C20]
Gender: Female, Male. Age: 18-64 years, 65+ years. Enrolment: 19.
Start date (EU): 2023-02-28. Decision date: 2024-05-22. Results received: No. Last updated: 2026-04-22.
Decision dates by country: DE: 2024-05-27, ES: 2024-05-22, FR: 2024-05-24

Condition(s): Systemic Lupus Erythematosus., Lupus Nephritis
Product: FLUDARABINE PHOSPHATE, CYCLOPHOSPHAMIDE, TOCILIZUMAB, YTB323

Primary endpoint: Safety parameters include vital signs, adverse events, laboratory parameters and ECG evaluation.
Endpoint(s): YTB323 transgene concentration by qPCR over time in peripheral blood; cellular kinetics parameters (Cmax, AUC, Tmax, T1/2, Clast, Tlast)., Pre-existing and treatment induced immunogenicity (cellular, humoral) of YTB323., Manufacture success (defined as meeting release specification and at or above the planned target dose)., At various timepoints: - SLEDAI-2K - Physician's global assessment - LLDAS - Remission (DORIS), UPCR at various timepoints., Complete Renal Response (CRR) at various timepoints.

Source: https://euclinicaltrials.eu/ctis-public/view/2023-510081-27-00